EU clinical trial 2025-520997-21-00: A Phase 2b, Randomized, Double-Blind, Placebo-Controlled Study to Evaluate the Efficacy and Safety of Tulisokibart in Participants With Psoriatic Arthritis.
Protocol code: MK-7240-015
Sponsor: Merck Sharp & Dohme LLC (Pharmaceutical company). Phase: Therapeutic exploratory (Phase II). Countries: Poland (ongoing, recruiting), Germany (ongoing, recruiting), Spain (ongoing, recruiting).
Therapeutic area(s): Diseases [C] - Musculoskeletal Diseases [C05]
Gender: Female, Male. Age: 18-64 years, 65+ years. Enrolment: 49.
Status: Ongoing, recruiting. Start date (EU): 2026-05-08. Decision date: 2026-04-30. Results received: No. Last updated: 2026-06-03.
Decision dates by country: ES: 2026-05-04, PL: 2026-04-30, DE: 2026-04-30

Condition(s): Psoriatic arthritis
Product: tulisokibart, Placebo to MK-7240

Primary endpoint: Number of Participants Achieving American College of Rheumatology 20% Response Criteria (ACR20) at Week 16
Endpoint(s): Number of Participants Achieving American College of Rheumatology 50% Response Criteria (ACR50) at Week 16, Number of Participants Achieving American College of Rheumatology 70% Response Criteria (ACR70) at Week 16, Mean Change from Baseline in the Health Assessment of Questionnaire Disability Index (HAQ-DI) at Week 16, Number of Participants Who Experience One or More Adverse Events (AEs), Number of Participants Who Discontinue Study Intervention Due to an AE

Source: https://euclinicaltrials.eu/ctis-public/view/2025-520997-21-00